EU clinical trial 2023-507486-26-00: First-in-human study of 225Ac-PSMA-Trillium (BAY 3563254) in participants with advanced metastatic castration-resistant prostate cancer (mCRPC)
Protocol code: 22049
Sponsor: Bayer Consumer Care AG (Pharmaceutical company). Phase: Human Pharmacology (Phase I)- First administration to humans. Countries: Belgium (ongoing, recruiting), Finland (ongoing, recruiting), Italy (ongoing, recruiting), Sweden (ongoing, recruiting), Netherlands (ongoing, recruiting).
Therapeutic area(s): Diseases [C] - Neoplasms [C04]
Gender: Male. Age: 18-64 years, 65+ years. Enrolment: 73.
Status: Ongoing, recruiting. Start date (EU): 2024-08-20. Decision date: 2024-01-30. Results received: No. Last updated: 2026-07-23.
Decision dates by country: SE: 2025-05-14, NL: 2025-06-16, BE: 2024-01-30, FI: 2025-05-30, IT: 2025-06-05

Condition(s): Advanced metastatic castration-resistant prostate cancer with prostate specific membrane antigen (PSMA) expression

Source: https://euclinicaltrials.eu/ctis-public/view/2023-507486-26-00